EU clinical trial 2023-504711-32-00: A Multi-Center, Open-Label Study of the Human Anti-TNF Monoclonal Antibody Adalimumab to Evaluate Long-Term Safety and Tolerability of Repeated Administration of Adalimumab in Pediatric Subjects with Ulcerative Colitis Who Completed the Study M11-290
Protocol code: M10-870
Sponsor: AbbVie Deutschland GmbH & Co. KG (Pharmaceutical company). Phase: Therapeutic confirmatory (Phase III). Countries: Slovakia (ended), Poland (ended).
Therapeutic area(s): Diseases [C] - Digestive System Diseases [C06]
Gender: Female, Male. Age: 0-17 years, 18-64 years. Enrolment: 46.
Status: Ended. Start date (EU): 2015-11-24. End date (EU): 2025-04-08. End date: 2025-04-09. Decision date: 2024-01-30. Results received: Yes. Last updated: 2025-06-13.
Decision dates by country: PL: 2024-02-02, SK: 2024-01-30

Condition(s): Ulcerative Colitis
Product: Humira 20 mg solution for injection in pre-filled syringe, Humira 40 mg solution for injection in pre-filled syringe, Humira 80 mg solution for injection in pre-filled syringe, Humira 40 mg/0.8 ml solution for injection

Primary endpoint: This study will utilize the PMS (and Mayo score if available) and PUCAI to determine efficacy of the study drug.
Endpoint(s): Safety analyses will be performed on all subjects who receive at least one dose of study drug.

Source: https://euclinicaltrials.eu/ctis-public/view/2023-504711-32-00